EU clinical trial 2022-502272-23-00: A multicenter uncontrolled, open label, prospective non-comparative single arm phase II study with bicalutamide (an antiandrogen) in combination with abemaciclib (an oral CDK 4/6 inhibitor) in 4 cohorts of locoregionally advanced inoperable or metastatic AR positive triple-negative breast cancer (AR+ TNBC).
Sponsor: UZ Leuven (Hospital/Clinic/Other health care facility). Phase: Therapeutic exploratory (Phase II). Countries: Belgium (ongoing, recruiting).
Therapeutic area(s): Diseases [C] - Neoplasms [C04]
Gender: Female. Age: 18-64 years, 65+ years. Enrolment: 53.
Status: Ongoing, recruiting. Start date (EU): 2024-04-08. Decision date: 2023-11-24. Results received: No. Last updated: 2026-02-27.

Condition(s): Locally advanced unresectable or metastatic androgen receptor positive triple negative breast cancer (or ER low HER2 negative breast cancer), progressive after at least 1 prior cytostatic regimen in advanced setting. If ER low additionally at least one line of endocrine therapy in advanced setting.
Product: Bicalutamide Teva 50 mg Filmtabletten, Verzenios 50 mg film-coated tablets

Primary endpoint: The DCR at 16 weeks of treatment with abemaciclib and bicalutamide in patients with metastatic AR+ TNBC (positive AR IHC in ≥1% of cells; cohorts A, B, C and D combined; patients treated at selected dose level) DCR at 16 weeks will be defined as the proportion of patients that present with stable disease, partial response or complete response per RECIST 1.1 at 16 weeks after treatment initiation.
Endpoint(s): The type, incidence, severity (as graded by the National Cancer Institute Common Terminology Criteria for Adverse Events [NCI CTCAE] v5.0), seriousness and relationship to study medications of Adverse Events (AEs) and any laboratory abnormalities., The DCR at 16 weeks for treatment with abemaciclib in combination with bicalutamide in the subgroup with IHC for AR > or =10%, The DCR at 16 weeks for treatment with abemaciclib in combination with bicalutamide in subgroups A, B, C and D separate., The DCR at 24 weeks for treatment with abemaciclib and bicalutamide in all patients and in the subgroups with IHC for AR > or =10%, Overall response rate (ORR) in all patients with measurable disease and in the subgroups with IHC for AR > or = 10%. ORR will be defined as the percentage of patients with measurable disease with complete response (CR) or partial response (PR) per RECIST 1.1., Duration of response (DOR) in all patients with measurable disease and in the subgroups with IHC for AR > or = 10%. DOR will be defined as the time measured from the first moment criteria for CR or PR are met until disease progression per RECIST 1.1 or death., Progression free survival (PFS) in all patients and in the subgroups with IHC for AR > or = 10%. PFS will be defined as the time from the start of treatment until disease progression per RECIST 1.1 or death from any cause., Overall survival (OS) in all patients and in the subgroups with IHC for AR > or = 10%. OS will be defined as the time from the start of treatment until death from any cause., Comparison of primary and secondary outcomes between patients with and without IHC for AR > or = 10%.

Source: https://euclinicaltrials.eu/ctis-public/view/2022-502272-23-00